EU clinical trial 2024-512491-35-00: Chronic kidney disease – imaging the metabolic derangements with ultra-sensitive MRI
Sponsor: Aarhus Universitet (Educational Institution). Phase: Therapeutic exploratory (Phase II). Countries: Denmark (ongoing, recruiting).
Therapeutic area(s): Analytical, Diagnostic and Therapeutic Techniques and Equipment [E] - Diagnosis [E01]
Gender: Female, Male. Age: 18-64 years, 65+ years. Enrolment: 40.
Status: Ongoing, recruiting. Start date (EU): 2024-04-01. Decision date: 2024-06-14. Results received: No. Last updated: 2026-06-03.

Condition(s): cronic kidney disease, Autosomal Dominant Polycystic kidney disease (ADPKD)
Product: Hyperpolarized [1-13C]pyruvate

Primary endpoint: MRI signature of the kidney
Endpoint(s): Measures of kidney function in blood and urine., Expired CO2 measures

Source: https://euclinicaltrials.eu/ctis-public/view/2024-512491-35-00